EU clinical trial 2024-512889-33-00: An open-label, roll-over study with rilpivirine in combination with a background regimen containing other antiretrovirals (ARVs) in human immunodeficiency virus type 1 (HIV-1) infected subjects who participated in rilpivirine pediatric studies.
Sponsor: Janssen Sciences Ireland Unlimited Company (Pharmaceutical company). Phase: Therapeutic exploratory (Phase II). Countries: Italy (ongoing, recruitment ended).
Therapeutic area(s): Diseases [C] - Virus Diseases [C02]
Gender: Female, Male. Age: 0-17 years, 18-64 years. Enrolment: 3.
Status: Ongoing, recruitment ended. Start date (EU): 2021-01-30. Decision date: 2024-08-12. Results received: No. Last updated: 2026-07-22.

Condition(s): HIV-1 Infection
Product: RILPIVIRINE, JNJ-16150108

Primary endpoint: No primary endpoint is defined for this study.

Source: https://euclinicaltrials.eu/ctis-public/view/2024-512889-33-00